EU clinical trial 2022-502991-21-00: Proof of concept study (multicenter, phase II) on the efficacy of the selective TYK2 inhibitor Deucravacitinib in Lichen planus patients (DEUCRALIP)
Protocol code: DER-202201
Sponsor: Rheinische Friedrich Wilhelms Universitaet Bonn (Educational Institution). Phase: Therapeutic exploratory (Phase II). Countries: Germany (ended).
Therapeutic area(s): Diseases [C] - Skin and Connective Tissue Diseases [C17]
Gender: Female, Male. Age: 18-64 years, 65+ years. Enrolment: 30.
Status: Ended. Start date (EU): 2024-05-22. End date (EU): 2026-06-24. Decision date: 2023-12-05. Results received: No. Last updated: 2026-02-09.

Condition(s): Lichen planus
Product: DEUCRAVACITINIB, Product name: Placebo to match deucravacitinib 6mg Name of manufacturer: Bristol-Myers Squibb (BMS) Ingredients: Lactose monohydrate, microcrystalline cellulose, magnesium stearate, and Opadry II coating Pharmaceutical form: Film-coated tablet, Age-appropriate oral solid dosage form

Primary endpoint: Change in the objective clinical symptoms (measured with the Lichen Planus Activity and Damage Index(LiPADI) Activity Score, from baseline (V1, day 1) to EOS (V4, day 112)
Endpoint(s): Change in the LiPADI Activity Score from baseline (V1) to V3, V4/OLE-V1, SC-1, SC-2, OLE-V2, SC-3 and OLE-V3 in both arms, Differences in IFN gene expression profile (CXCL10, CXCL9, CCL5, MxA, BLyS, TRAIL etc.) in peripheral blood and skin or (only in case of solely oral involvement) in lesional oral mucosa (BOS/V1, EOS/V4, OLE-V3) between placebo and treatment arm, Change in IFN gene expression profile (CXCL10, CXCL9, CCL5, MxA, BLyS, TRAIL etc.) in peripheral blood and skin or (only in case of solely oral involvement) in lesional oral mucosa (BOS/V1 vs EOS/V4 vs OLE-V3) in both arms, Change of DLQI from baseline (V1) to EOS (V4) between placebo and treatment arm, Change of DLQI from baseline (V1) to V3, V4/OLE-V1, SC-1, SC-2, OLE-V2, SC-3, OLE-V3 in both arms, Change of Itch NRS from baseline (V1) to EOS (V4) between placebo and treatment arm, Change of Itch NRS from baseline (V1) to V3, V4/OLE-V1, SC-1, SC-2, OLE-V2, SC-3, OLE-V3 in both arms, Change in the amount of steroids used from baseline (V1) to EOS (V4) between placebo and treatment arm

Source: https://euclinicaltrials.eu/ctis-public/view/2022-502991-21-00